EU clinical trial 2024-518015-19-00: A Phase 2, Randomized, Open-Label Study Comparing Telisotuzumab Adizutecan (ABBV-400) Monotherapy to the Current Standard of Care in Subjects with Post Adjuvant ctDNA Positive Colorectal Cancer and No Radiographic Evidence of Disease (NED)
Protocol code: M24-534
Sponsor: AbbVie Deutschland GmbH & Co. KG (Pharmaceutical company). Phase: Therapeutic exploratory (Phase II). Countries: Italy (ongoing, recruiting), Spain (ongoing, recruiting), Denmark (ongoing, recruiting), Belgium (ongoing, recruiting).
Therapeutic area(s): Diseases [C] - Neoplasms [C04]
Gender: Female, Male. Age: 18-64 years, 65+ years. Enrolment: 24.
Status: Ongoing, recruiting. Start date (EU): 2025-09-24. Decision date: 2025-07-29. Results received: No. Last updated: 2026-06-22.
Decision dates by country: DK: 2025-07-29, BE: 2026-02-24, IT: 2025-07-30, ES: 2025-07-30

Condition(s): Colorectal Cancer
Product: Telisotuzumab adizutecan

Primary endpoint: Percentage of Participants with disease free survival (DFS) Event
Endpoint(s): Change in Circulating Tumor Deoxyribonucleic Acid (ctDNA) Clearance at 6 months, Overall Survival (OS)

Source: https://euclinicaltrials.eu/ctis-public/view/2024-518015-19-00